EU clinical trial 2023-508150-26-00: To assess the relative BA of a low-strength FDC tablet formulation of niraparib plus AA compared to niraparib and AA co-administered as single agents after single dose administration and to assess BE of a regular strength FDC tablet formulation of niraparib plus AA compared to niraparib and AA co-administered as single agents at steady state in men with prostate cancer
Protocol code: 67652000PCR1001
Sponsor: Janssen Cilag International (Pharmaceutical company). Phase: Human Pharmacology (Phase I)- Bioequivalence Study. Countries: Spain (ongoing, recruitment ended), Netherlands (ongoing, recruitment ended), Poland (ongoing, recruitment ended).
Therapeutic area(s): Diseases [C] - Neoplasms [C04]
Gender: Male. Age: 18-64 years, 65+ years. Enrolment: 41.
Status: Ongoing, recruitment ended. Start date (EU): 2020-11-26. Decision date: 2024-05-06. Results received: No. Last updated: 2025-11-17.
Decision dates by country: NL: 2024-05-06, PL: 2024-05-07, ES: 2024-05-09

Condition(s): Metastatic castration-resistant prostate cancer (mCRPC)

Source: https://euclinicaltrials.eu/ctis-public/view/2023-508150-26-00